EU clinical trial 2024-512504-19-00: A study to test different doses of BI 1831169 alone and in combination with an anti-PD-1 antibody in people with different types of advanced cancer (solid tumors)
Protocol code: 1456-0001
Sponsor: Boehringer Ingelheim International GmbH (Pharmaceutical company). Phase: Human Pharmacology (Phase I)- First administration to humans. Countries: France (temporarily halted), Germany (temporarily halted), Belgium (temporarily halted), Austria (temporarily halted), Spain (temporarily halted), Italy (authorised, recruitment pending).
Therapeutic area(s): Diseases [C] - Neoplasms [C04]
Gender: Female, Male. Age: 18-64 years, 65+ years. Enrolment: 91.
Start date (EU): 2025-05-28. Decision date: 2024-07-23. Results received: No. Last updated: 2026-08-07.
Decision dates by country: IT: 2025-04-03, DE: 2024-07-26, AT: 2024-07-29, FR: 2024-07-25, ES: 2024-07-23, BE: 2024-07-23

Condition(s): solid tumors

Source: https://euclinicaltrials.eu/ctis-public/view/2024-512504-19-00